EU clinical trial 2024-512828-12-00: An open-label study to collect safety and effectiveness information on long-term treatment with vamorolone in boys with Duchenne Muscular Dystrophy who have completed prior studies with vamorolone (The GUARDIAN Study)
Protocol code: SNT-IV-VAM-011
Sponsor: Santhera Pharmaceuticals (Schweiz) AG (Pharmaceutical company). Phase: Therapeutic use (Phase IV). Countries: Czechia (ongoing, recruitment ended), Spain (ongoing, recruitment ended), Belgium (ongoing, recruitment ended), Greece (ongoing, recruitment ended), Ireland (ongoing, recruitment ended), Netherlands (ongoing, recruitment ended).
Therapeutic area(s): Diseases [C] - Musculoskeletal Diseases [C05]
Gender: Male. Age: 0-17 years. Enrolment: 26.
Status: Ongoing, recruitment ended. Start date (EU): 2024-12-05. Decision date: 2024-10-04. Results received: No. Last updated: 2026-06-15.
Decision dates by country: GR: 2025-04-15, CZ: 2024-10-08, BE: 2024-10-04, ES: 2024-10-07, IE: 2025-02-21, NL: 2025-02-03

Condition(s): Duchenne Muscular Dystrophy
Product: AGAMREE 40 mg/ml oral suspension

Primary endpoint: Number of vertebral fractures per 1000 person-years based on X- ray central reading
Endpoint(s): Time to first vertebral fractures (cumulative incidence), Number of non-vertebral fractures per 1000 person-years based on investigator reporting, Time to first non-vertebral fractures (cumulative incidence), Number of cataracts per 1000 person-years based on ophthalmologist assessment, Number of subjects not reaching Tanner stage 2 by 15 years of age, Frequency of adverse events (AEs) and serious adverse events (SAEs), Change from baseline in body weight, height and body mass index (BMI), Number of subjects with clinically relevant laboratory abnormalities including glycosylated haemoglobin (HbA1c), and morning cortisol, Change from baseline in Time to Stand Test (TTSTAND) velocity, 6-Minute Walk Test (6MWT) distance, Change from baseline in 6MWT distance, NorthStar Ambulatory Assessment (NSAA) scores, Age at ambulatory and non-ambulatory milestones

Source: https://euclinicaltrials.eu/ctis-public/view/2024-512828-12-00